EU clinical trial 2023-510217-26-00: Normothermic intraperitoneal chemotherapy – long term in peritoneal metastases from colorectal cancer – feasibility study
Protocol code: NIPEC-OXA
Sponsor: Oslo University Hospital HF (Hospital/Clinic/Other health care facility). Phase: Human Pharmacology (Phase I)- Other. Countries: Norway (ongoing, recruiting).
Therapeutic area(s): Diseases [C] - Digestive System Diseases [C06]; Diseases [C] - Neoplasms [C04]
Gender: Female, Male. Age: 18-64 years, 65+ years. Enrolment: 20.
Status: Ongoing, recruiting. Start date (EU): 2024-11-14. Decision date: 2024-11-14. Results received: No. Last updated: 2024-11-14.

Condition(s): colorectal cancer with peritoneal metastasis

Source: https://euclinicaltrials.eu/ctis-public/view/2023-510217-26-00